EU clinical trial 2025-522421-36-00: Phase IV, open-label, randomized clinical trial on the effect of intravenous iron on quality of life in elderly patients with Acute Coronary Syndrome.
Protocol code: HI-COR-65
Sponsor: Instituto De Investigacion Sanitaria Fundacion Para La Investigacion Del Hospital Clinico De Valencia-INCLIVA (Hospital/Clinic/Other health care facility). Phase: Therapeutic use (Phase IV). Countries: Spain (ongoing, recruiting).
Therapeutic area(s): Diseases [C] - Cardiovascular Diseases [C14]
Gender: Female, Male. Age: 65+ years. Enrolment: 538.
Status: Ongoing, recruiting. Start date (EU): 2026-02-27. Decision date: 2025-12-03. Results received: No. Last updated: 2025-12-03.

Condition(s): Acute coronary syndrome
Product: Ferinject 50 mg/ml dispersión inyectable y para perfusión

Primary endpoint: Change in EQ-5D-5L score at 6 and 12 months vs. baseline (IV iron group vs. control).
Endpoint(s): Change in FRAIL Scale score at 6 and 12 months vs. baseline., Change in CRP and hs-CRP levels from baseline to 12 months., Incidence of decompensated heart failure requiring hospitalization (12 months)., Incidence of non-fatal myocardial infarction (1 year)., Incidence of stroke (1 year)., All-cause mortality at 12 months., Change in iron metabolism markers (iron, ferritin, serum ferritin, sTfR, TSAT, HIF-1, hepcidin) from baseline to 12 months (subgroup)., Change in inflammatory markers (CRP, hs-CRP, IL-1, IL-6, IL-10, IL-18, TNF-α) from baseline to 12 months (subgroup)., Change in biological age markers from baseline to 12 months (subgroup)., Change in telomere length from baseline to 12 months (subgroup)., Correlation of baseline Klotho and FGF23 values with adverse clinical events (HF decompensation, reinfarction, stroke, all-cause mortality) at 12 months (subgroup).

Source: https://euclinicaltrials.eu/ctis-public/view/2025-522421-36-00